EU clinical trial 2024-516162-11-00: A Phase III, Multicenter, Randomized, Double-Blind, Placebo-Controlled Study Evaluating the Efficacy and Safety of Inavolisib Plus a CDK4/6 Inhibitor and Letrozole Versus Placebo Plus a CDK4/6 Inhibitor and Letrozole in Patients with Endocrine-Sensitive PIK3CA -Mutated, Hormone Receptor-Positive, HER2- Negative Advanced Breast Cancer
Protocol code: WO45654
Sponsor: F. Hoffmann-La Roche AG (Pharmaceutical company). Phase: Therapeutic confirmatory (Phase III). Countries: Germany (ongoing, recruiting), Italy (ongoing, recruiting), France (ongoing, recruiting), Poland (ongoing, recruiting), Spain (ongoing, recruiting).
Therapeutic area(s): Diseases [C] - Neoplasms [C04]
Gender: Female, Male. Age: 18-64 years, 65+ years. Enrolment: 176.
Status: Ongoing, recruiting. Start date (EU): 2025-07-14. Decision date: 2025-04-07. Results received: No. Last updated: 2026-07-21.
Decision dates by country: FR: 2025-04-07, DE: 2025-04-16, IT: 2025-04-11, ES: 2025-04-07, PL: 2025-04-28

Condition(s): Endocrine-Sensitive phosphatidylinositol 3-kinase (PIK3CA)-Mutated, Hormone Receptor-Positive, human epidermal growth factor receptor 2- (HER2-) negative advanced breast cancer
Product: INAVOLISIB, RIBOCICLIB, LETROZOLE, IBRANCE 125 mg film-coated tablets, LETROZOLE ACCORD HEALTHCARE 2,5 mg, comprimé pelliculé, PALBOCICLIB, PALBOCICLIB, IBRANCE 100 mg film-coated tablets, Inavolisib placebo, Letrozol STADA® 2,5 mg Filmtabletten, PALBOCICLIB, IBRANCE 75 mg film-coated tablets, INAVOLISIB, RIBOCICLIB

Primary endpoint: 1. Time from randomization to the first occurrence of disease progression, as determined by the investigator according to response evaluation criteria in solid tumors, Version 1.1 (RECIST v1.1), or death from any cause (whichever occurs first)
Endpoint(s): 1. Time from randomization to death from any cause, 2. Investigator-assessed confirmed objective response rate (ORR), defined as the proportion of participants with a complete response (CR) and/or partial response (PR) on at least two consecutive ≥ 4 weeks apart, as determined by the investigator according to RECIST v1.1, 3. Investigator-assessed duration of response (DOR), defined as the time from the first occurrence of a confirmed objective response to the first occurrence of disease progression as determined by the investigator according to RECIST v1.1 or death from any cause (whichever occurs first), 4. Investigator-assessed clinical benefit rate (CBR), defined as the proportion of participants with a CR, PR, and/or stable Disease (SD) for at least 24 weeks, as determined by the investigator according to RECIST v1.1, 5. Time to confirmed deterioration (TTCD) in pain, defined as the time from randomization to the first documentation of a ≥ 2-point increase from baseline held for two consecutive timepoints on the "worst pain" item from the Brief Pain Inventory-Short Form (BPI-SF), 6. TTCD in Physical Function, defined as the time from randomization to the first documentation of a ≥ 10-point decrease from baseline held for two consecutive timepoints on the European Organisation for Research and Treatment of Cancer Quality of Life-Core 30 Questionnaire (EORTC QLQ-C30) Physical Function scale (items 1-5), 7. TTCD in Role Function, defined as the time from randomization to the first documentation of a ≥ 10-point decrease from baseline held for two consecutive timepoints on the EORTC QLQ-C30 Role Function scale (items 6 and 7), 8. TTCD in HRQoL, defined as the time from randomization to the first documentation of a ≥ 10- point decrease from baseline held for two consecutive timepoints on the EORTC QLQ-30 GHS/QoL scale (items 29 and 30), 9. Incidence and severity of adverse events, with severity determined according to the national cancer institute common terminology criteria for adverse events (NCI CTCAE) v5.0, 10. Change from baseline in targeted vital signs, 11. Change from baseline in targeted clinical laboratory test results, 12. Presence, frequency of occurrence, severity, and/or degree of interference with daily activities of symptomatic treatment toxicities (i.e., diarrhea, nausea, vomiting, decreased appetite, fatigue, mouth sores, rash, muscle pain, joint pain, hot flashes and vaginal dryness), as assessed through use of the National Cancer Institute Patient Reported Outcomes Common Terminology Criteria for Adverse Events (NCI PRO-CTCAE) instrument, 13. Proportion of participants reporting each response option at each assessment timepoint by treatment arm for treatment side-effect bother single-item General Population, Question 5 (GP5) from the functional assessment of cancer therapy-general questionnaire (FACT-G), 14. Change from baseline in symptomatic treatment toxicities and treatment side-effect bother as assessed through use of the PRO-CTCAE and FACT-G GP5 item, respectively

Source: https://euclinicaltrials.eu/ctis-public/view/2024-516162-11-00